EU clinical trial 2024-511459-16-00: Phase Ib-II, non-randomized, open-label study of Tumor Treating Fields (TTFields, 150kHz) concomitant with modFOLFIRINOX for front-line treatment of metastatic pancreatic adenocarcinoma
Protocol code: NOVOFFOX
Sponsor: Clinica Universidad De Navarra (Hospital/Clinic/Other health care facility). Phase: Phase I and Phase II (Integrated)- Other. Countries: Spain (ongoing, recruiting).
Therapeutic area(s): Diseases [C] - Neoplasms [C04]
Gender: Female, Male. Age: 18-64 years, 65+ years. Enrolment: 30.
Status: Ongoing, recruiting. Start date (EU): 2025-10-14. Decision date: 2025-02-10. Results received: No. Last updated: 2026-02-09.

Condition(s): Histologically confirmed pancreatic adenocarcinoma with liver metastases, with no previous systemic treatment in the metastatic setting
Product: CALCIUM FOLINATE, OXALIPLATIN, FLUOROURACIL, IRINOTECAN

Primary endpoint: Toxicity profile in patients with mPDAC treated at 1L with TTFields concomitantly with modFOLFIRINOX, measured by the rate of patients with treatment-emergent adverse events (TEAEs), using CTCAE v5.0.
Endpoint(s): Total hours with TTField device functioning during every 14 days chemotherapy cycle, QoL assessed using EORTC QLQ-30 questioner, Progression-free survival (PFS): defined as the time from first modFOLFIRINOX administration until disease progression based on CT scan collected on the study according to RECIST 1.1 criteria or any cause related death, whichever occurs first, Overall survival (OS): defined as the time from first modFOLFIRINOX administration until patient death, Overall response rate (ORR): defined as the percentage of patients with complete response (CR) or partial response (PR) as best overall response (BOR) according to RECIST 1.1, Disease control rate (DCR): defined as the percentage of patients with CR or PR and the percentage of subjects with stable (SD) of at least 12 weeks duration as BOR according to RECIST 1.1

Source: https://euclinicaltrials.eu/ctis-public/view/2024-511459-16-00